EU clinical trial 2024-516290-67-00: A PHASE 1/2, OPEN-LABEL, MULTICENTER STUDY TO INVESTIGATE THE SAFETY, PHARMACOKINETICS AND EFFICACY OF CYC140, AN ORAL PLK1 INHIBITOR, IN SUBJECTS WITH ADVANCED SOLID TUMORS AND LYMPHOMA
Protocol code: CYC140-101
Sponsor: Cyclacel Limited (Pharmaceutical company). Phase: Phase I and Phase II (Integrated)- Other. Countries: Spain (ended).
Therapeutic area(s): Diseases [C] - Neoplasms [C04]
Gender: Female, Male. Age: 18-64 years, 65+ years. Enrolment: 56.
Status: Ended. Start date (EU): 2022-08-03. End date (EU): 2025-01-07. Decision date: 2024-08-13. Results received: No. Last updated: 2024-08-13.

Condition(s): ADVANCED SOLID TUMORS AND LYMPHOMA

Primary endpoint: Phase 1: dose escalation • The incidence rate of dose-limiting toxicities (first cycle only) at each dose level, Phase 2: proof of concept • ORR according to Response Evaluation Criteria in Solid Tumors: RECIST guidelines (version 1.1, 2009) (Lugano Criteria for lymphoma, mSWAT for CTCL) for each tumor type. The overall response rate is defined as proportion of subjects who had the best overall response (BOR) of complete response (CR) or partial response (PR)
Endpoint(s): Phase 1 dose escalation, Phase 2 proof of concept: Safety: Type, frequency and severity of adverse drug reactions according to National Cancer Institute CTCAE (version 5.0)., DCR is defined as the proportion of subjects who achieve a response of CR, PR and stable disease according to RECIST., Response rate as per Lugano Criteria for lymphoma, mSWAT for CTCL., Progression-free survival (PFS) is defined as the time from the first dose date to objectively documented disease progression or death., Duration of response, computed for subjects with a BOR of CR or PR, is defined as the time between the date of first response and the subsequent date of objectively documented disease progression or death., Overall survival is defined as the time between the first dosing date and the date of death., Exploratory: Phase 1 dose escalation, Phase 2 proof of concept • Pharmacodynamics: PLK1 and BRD4 inhibition assessed by differential expression of target genes (such as MYC, PLK1, CDKN1A, HEXIM1) relative to baseline (Phase 1 only) • PGx: Plasma cell-free DNA mutation and copy number variation profile determined by NGS.

Source: https://euclinicaltrials.eu/ctis-public/view/2024-516290-67-00